EU clinical trial 2024-515459-39-00: A Phase I/II, Open-Label, Multicenter Study of ALE.P02 (Claudin-1 Targeted Antibody-Drug Conjugate) as a Monotherapy or in Combination with pembrolizumab (anti-PD-1 antibody) in Adult Patients with Selected Advanced or Metastatic CLDN1+ Squamous Solid Tumors
Protocol code: ALE.P02.01
Sponsor: Alentis Therapeutics AG (Pharmaceutical company). Phase: Phase I and Phase II (Integrated)- First administration to humans. Countries: Italy (authorised, recruiting), Spain (ongoing, recruiting), France (authorised, recruiting).
Therapeutic area(s): Diseases [C] - Neoplasms [C04]
Gender: Female, Male. Age: 18-64 years, 65+ years. Enrolment: 104.
Start date (EU): 2025-05-08. Decision date: 2025-04-11. Results received: No. Last updated: 2026-06-09.
Decision dates by country: ES: 2025-04-11, IT: 2025-04-14, FR: 2025-04-11

Condition(s): Advanced or Metastatic Squamous Solid Tumors
Product: KEYTRUDA 25 mg/mL concentrate for solution for infusion.

Primary endpoint: Incidence of DLTs, Incidence and severity of AEs, SAEs, Clinically significant changes in laboratory values, vital signs, and electrocardiograms, Tolerability: dose interruptions and dose intensity, Preliminary efficacy parameters per RECIST 1.1: • ORR defined as CR rate + PR rate • DoR: duration of response Note: CLDN1 and indication subgroup analysis will also be performed, ORR defined as CR rate + PR rate per RECIST 1.1, DoR: duration of response Note: CLDN1 and indication subgroup analysis will also be performed
Endpoint(s): DCR defined as CR rate + PR rate + SD rate per RECIST 1.1, Median PFS (and rate at 6 and 12 months) per RECIST 1.1, Median OS and rate of 6-month, 12-month, and 24-month survival, Blood concentration: concentration of ALE.P02 ADC, total antibody and MMAE (payload), PK parameters including, but not limited to AUCtau, AUClast, AUCinf, Cmax, Cmin, Ctrough, Kel, t ½, Tmax, Cavg and other parameters as appropriate for ALE.P02 ADC, total antibody and MMAE, Presence of anti-ALE.P02 antibodies with screening and confirmatory assay, as appropriate, Incidence and severity of AEs and SAEs, Clinically significant changes in laboratory values, vital signs, and electrocardiograms, Tolerability: dose interruptions and dose intensity

Source: https://euclinicaltrials.eu/ctis-public/view/2024-515459-39-00